EU clinical trial 2024-514035-19-00: PErsonalized Addition of Recombinant LH in suboptimal responders >35 years old (POSEIDON group 2). A randomized controlled trial
Sponsor: Santiago Dexeus Font Fundacio Privada (Laboratory/Research/Testing facility). Phase: Therapeutic use (Phase IV). Countries: Spain (ongoing, recruiting).
Therapeutic area(s): Diseases [C] - Female Urogenital Diseases and Pregnancy Complications [C13]
Gender: Female. Age: 18-64 years. Enrolment: 120.
Status: Ongoing, recruiting. Start date (EU): 2024-09-23. Decision date: 2024-09-23. Results received: No. Last updated: 2024-09-23.

Condition(s): infertility
Product: Crinone 8% gel vaginal, Cetrotide 0.25 mg powder and solvent for solution for injection, GONAL-f 900 IU/1.44 mL solution for injection in pre-filled pen, Ovitrelle 250 micrograms solution for injection in pre-filled pen, Pergoveris (900 IU + 450 IU)/1.44 mL solution for injection in pre-filled pen

Primary endpoint: The primary efficacy endpoint is serum progesterone levels as well as P4/E2 ratio on the day of ovulation triggering. The primary efficacy endpoint is related to the primary trial objective.
Endpoint(s): Serum levels of estradiol, FSH, Testosterone and LH levels and P4/E2 ratio on days 1, 6, 8, 10 and the final day of oocyte maturation., Progesterone-to-follicle Index (PFI) on the day of ovulation triggering, Number of oocytes., Number of patients with optimal number of oocytes retrieved (≥10 oocytes)., Number of embryos., Good-quality embryos., Number of blastocysts., Clinical pregnancy defined as the presence of intrauterine gestational sac at 6-7 weeks of gestation., Ongoing pregnancy defined as the presence of intrauterine gestational sac with an embryonic pole demonstrating cardiac activity at 8-9 weeks of gestation.

Source: https://euclinicaltrials.eu/ctis-public/view/2024-514035-19-00